EU clinical trial 2024-514350-78-00: FERTICSI :Improvement of Live Babies Rates After ICSI, Using cpFT : A multicenter, prospective, randomized study
Protocol code: P170706J
Sponsor: Assistance Publique Hopitaux De Paris (Hospital/Clinic/Other health care facility). Phase: Therapeutic confirmatory (Phase III). Countries: France (ongoing, recruitment ended).
Therapeutic area(s): Diseases [C] - Female Urogenital Diseases and Pregnancy Complications [C13]
Gender: Female, Male. Age: 18-64 years. Enrolment: 366.
Status: Ongoing, recruitment ended. Start date (EU): 2021-07-29. Decision date: 2024-10-28. Results received: No. Last updated: 2025-08-14.

Condition(s): Infertility
Product: cpFT

Primary endpoint: Live Baby birth rate after the first embryo transfer for women under 37 years of age.
Endpoint(s): 1. Number of Metaphase 2 oocyte at decoronization and before ICSI over of the total number of oocytes collected,, 2. Blastoformation rate and number of embryo culture failures,, 3. Kinetics of embryonic development analyzed on videos from incubators equipped with recording cameras., 4. Blastocysts quality according to Gardner classification,, 5. Survival rate and blastocysts quality according to Gardner classification after thawing,, 6. βhCG level greater than 1000 over the number of embryos transferred,, 7. Number of pregnancies with cardiac activity on the 12th week ultrasound,, 8. Number of miscarriages over the number of pregnancies with positive cardiac activity., 9. Pregnancy and ectopic pregnancy rates. Rate of pregnancy therapeutic termination and rate of anomaly on morphological ultrasounds at 6 months and malformation at birth. Record of the term of delivery, weight, height and head circumference of the baby at birth., 10. Analysis of examinations carried out during pediatric consultations until the child is 1 year old (status-weight curve, Denver and Brunet Lezine scales,), 11. Weight of the placenta; Study of DNA, RNA, Western-Blot, Methylation, histological study

Source: https://euclinicaltrials.eu/ctis-public/view/2024-514350-78-00